EU clinical trial 2024-512128-12-01: Digi-Panc-1; A prospective single-arm pilot phase II trial of digitoxin in combination with chemotherapy for patients with inoperable pancreatic cancer
Protocol code: Digi-Panc-1
Sponsor: Vaestra Goetalandsregionen (Hospital/Clinic/Other health care facility). Phase: Therapeutic exploratory (Phase II). Countries: Sweden (ongoing, recruiting).
Therapeutic area(s): Diseases [C] - Neoplasms [C04]
Gender: Female, Male. Age: 18-64 years, 65+ years. Enrolment: 50.
Status: Ongoing, recruiting. Start date (EU): 2025-11-11. Decision date: 2024-12-11. Results received: No. Last updated: 2024-12-11.

Condition(s): Pancreatic cancer
Product: Digitoxin AWD 0,07 0,07 mg/Tablette

Primary endpoint: Progression free survival at 1 year; from the date of enrollment, i.e. from start to take digitoxin tablets.
Endpoint(s): Overall survival at 1 year., Progression-free survival defined as the time from enrollment until the earliest date of disease progression determined by assessment of objective radiographic disease per RECIST (v1.1)., Objective response rate and duration of response determined by radiographic disease assessments per RECIST (v1.1)., Safety and tolerability of the treatment regimens by assessment of adverse events and changes in safety assessments including laboratory parameters., Biochemical response: change in serum tumor markers (CA19-9, CEA, CA125) before start of digitoxin tablets as baseline and at every 3 months evaluation., Quality of Life according to EORTC QLQ-C30 and EORTC QLQ-PAN-26., Translational studies: Cytokines pivotal for cancer and inflammation will be analyzed. More than 40 cytokines will be examined before start of digitoxin and at 3 months of treatment with digitoxin.

Source: https://euclinicaltrials.eu/ctis-public/view/2024-512128-12-01